EU clinical trial 2024-513097-21-00: Phase 1 study to evaluate [18F]ACI-19626 as a potential PET radioligand for imaging TDP-43 inclusions in the brain of patients with suspected TDP-43 proteinopathies compared with healthy controls
Protocol code: ACI-19626-FTD-2301
Sponsor: AC Immune SA (Pharmaceutical company). Phase: Human Pharmacology (Phase I)- First administration to humans. Countries: Netherlands (ongoing, recruiting).
Therapeutic area(s): Diseases [C] - Nervous System Diseases [C10]
Gender: Female, Male. Age: 18-64 years, 65+ years. Enrolment: 45.
Status: Ongoing, recruiting. Start date (EU): 2024-11-20. Decision date: 2024-10-30. Results received: No. Last updated: 2025-04-01.

Condition(s): Alzheimer's Disease, Familial and sporadic Amyotrophic lateral sclerosis, Familial and sporadic Frontotemporal dementia, Suspected limbic predominant age-related TDP-43 Encephalopathy (LATE)

Source: https://euclinicaltrials.eu/ctis-public/view/2024-513097-21-00